EU clinical trial 2024-519563-18-00: A Multicenter, Open-label, Phase 2 Basket Study of MK-5684 in Participants With Selected Solid Tumors (OMAHA-015)
Protocol code: MK-5684-015
Sponsor: Merck Sharp & Dohme LLC (Pharmaceutical company). Phase: Phase II and Phase III (Integrated). Countries: Spain (ongoing, recruiting).
Therapeutic area(s): Diseases [C] - Neoplasms [C04]
Gender: Female, Male. Age: 18-64 years, 65+ years. Enrolment: 22.
Status: Ongoing, recruiting. Start date (EU): 2025-09-02. Decision date: 2025-08-21. Results received: No. Last updated: 2026-05-07.

Condition(s): Breast cancer, Ovarian cancer, Endometrial cancer
Product: MEDROXYPROGESTERONE, Opevesostat, EXEMESTANE, LETROZOLE, MEGESTROL, FLUDROCORTISONE, TAMOXIFEN, FULVESTRANT, HYDROCORTISONE, DEXAMETHASONE

Primary endpoint: Progression Free Survival (PFS) – All Cohorts
Endpoint(s): Overall Survival (OS) – All Cohorts, Clinical Benefit Rate (CBR) – Cohort A, Objective Response Rate (ORR) – All Cohorts, Duration of Response (DOR) – All Cohorts, Number of Participants who Experience One or More Adverse Events (AEs) – All Cohorts, Number of Participants who Discontinue Study Intervention Due to an AE – All Cohorts

Source: https://euclinicaltrials.eu/ctis-public/view/2024-519563-18-00